EU clinical trial 2024-517606-29-00: TENECTEPLASE IN CENTRAL RETINAL ARTERY OCCLUSION STUDY (TenCRAOS): A Prospective, randomised-controlled, double-dummy, double-blind phase 3 multi-centre trial of TNK 0.25 mg/kg + placebo vs. ASA + placebo (2 arms with 1:1 block randomisation)
Sponsor: Oslo University Hospital HF (Hospital/Clinic/Other health care facility). Phase: Therapeutic confirmatory (Phase III). Countries: Ireland (authorised, recruitment pending), Norway (authorised, recruiting), Belgium (authorised, recruitment pending), Denmark (authorised, recruitment pending), Finland (authorised, recruitment pending), Sweden (authorised, recruitment pending).
Therapeutic area(s): Diseases [C] - Eye Diseases [C11]; Diseases [C] - Nervous System Diseases [C10]; Diseases [C] - Cardiovascular Diseases [C14]
Gender: Female, Male. Age: 18-64 years, 65+ years. Enrolment: 76.
Start date (EU): 2020-10-30. Decision date: 2024-10-31. Results received: No. Last updated: 2024-11-05.
Decision dates by country: BE: 2024-11-04, DK: 2024-11-04, FI: 2024-11-01, IE: 2024-10-31, SE: 2024-10-31, NO: 2024-11-05

Condition(s): Central retinal artery occlusion
Product: encapsulated tablets of inactive substance, Albyl-E 75 mg enterotabletter, TENECTEPLASE, Sodium Chloride Fresenius Kabi Italia 0.9 % Solution for infusion

Primary endpoint: Proportion of patients with ≤ 0.7 logMAR best-corrected visual acuity in the affected eye at 30 (±5) days after treatment, representing an improvement in best-corrected visual acuity of at least 0.3 logMAR (intention-to-treat (ITT) analysis).

Source: https://euclinicaltrials.eu/ctis-public/view/2024-517606-29-00